EU clinical trial 2022-500828-30-00: A Randomized, Placebo-controlled, Double-blind, Parallel group, 6 Month Study to Evaluate the Safety, Tolerability, and Potential Efficacy of Monthly Trappsol® Cyclo™ (hydroxypropyl beta cyclodextrin, HPβCD) Infusions in Patients With Early Alzheimer’s Disease
Protocol code: CTD-TCAD-501
Sponsor: Cyclo Therapeutics Inc. (Pharmaceutical company). Phase: Therapeutic exploratory (Phase II). Countries: Austria (not authorised), Germany (not authorised).
Therapeutic area(s): Diseases [C] - Nervous System Diseases [C10]
Gender: Female, Male. Age: 18-64 years, 65+ years. Enrolment: 60.
Status: Not authorised. Decision date: 2022-09-16. Results received: No. Last updated: 2022-09-19.
Decision dates by country: AT: 2022-09-19, DE: 2022-09-16

Condition(s): Early Alzheimer´s Disease
Product: Trappsol Cyclo, Sodium chloride 0.45% solution for infusion

Primary endpoint: Full details of primary endpoint being Safety and Pharmacokinetic Endpoints are outlined in section 3.1 and 3.4 of the Study Protocol (CTD-TCAD-501, Version 2.0, Final, 31 Mar 2022). • Incidence and severity of TEAEs • Adverse events of special interest (AESIs): o MRI assessments of ARIA-H or ARIA E o Hearing loss based audiological examination o Infusion reactions • Vital signs and/or physical examinations • Safety clinical laboratory values (hematology, clinical chemistry, and urinalysis) i

Source: https://euclinicaltrials.eu/ctis-public/view/2022-500828-30-00